EU clinical trial 2023-503497-21-00: A Phase 3, Open-Label Extension Study to Evaluate the Long-Term Safety and Efficacy of Fazirsiran in Participants With Alpha-1 Antitrypsin Deficiency-Associated Liver Disease
Protocol code: TAK-999-3003
Sponsor: Takeda Development Center Americas Inc. (Pharmaceutical company). Phase: Therapeutic confirmatory (Phase III). Countries: Austria (ongoing, recruiting), Germany (ongoing, recruiting), Portugal (ongoing, recruiting).
Therapeutic area(s): Diseases [C] - Nutritional and Metabolic Diseases [C18]
Gender: Female, Male. Age: 18-64 years, 65+ years. Enrolment: 15.
Status: Ongoing, recruiting. Start date (EU): 2023-07-24. Decision date: 2023-07-04. Results received: No. Last updated: 2026-07-10.
Decision dates by country: AT: 2023-07-17, PT: 2023-07-05, DE: 2023-07-04

Condition(s): Alpha-1 Antitrypsin Deficiency-Associated Liver Disease
Product: Fazirsiran

Primary endpoint: The primary safety endpoints for this study to be assessed over time and through the end of study (EOS) are: •AEs and SAEs including any pulmonary AEs or SAEs indicative of worsening pulmonarycondition or function (for example, pulmonary exacerbation, respiratory infection, significant pulmonary function test [PFT] decline.), •Change from baseline in pulmonary function parameters: – FEV1 (L) and percent predicted forced expiratory volume in the first second of expiration (ppFEV1 [%]). – FVC; L and percent predicted FVC (ppFVC; %). – FEV1/FVC ratio. – Diffusing capacity of lung for carbon monoxide (DLCO; mL/min/mm Hg) and percent predicted DLCO (ppDLCO; %). – DLCOhgb; mL/min/mm Hg and percent predicted DLCOhgb (ppDLCOhgb; %)., Translation PT, •Vital signs., •Change from baseline in clinical laboratory values (hematology, biochemistry including liver tests, coagulation, and urinalysis results).
Endpoint(s): •No progression from baseline of at least 1 stage of histologic fibrosis (by METAVIR staging) on liver biopsy at Week 102 (Yes/No), •In participants with baseline fibrosis of F1 or higher, a decrease from baseline of at least 1 stage of histologic fibrosis (by METAVIR staging) on liver biopsy at Week 102 (Yes/No), •Change from baseline in intrahepatic Z-AAT protein polymer burden assessed by periodic acid Schiff plus diastase (PAS+D) staining in liver biopsy at Week 102., •Change from baseline in intrahepatic portal inflammation in Week 102 liver biopsy., •Change from baseline in liver stiffness assessed by magnetic resonance elastography (MRE) (at select sites)., •Change from baseline in liver stiffness assessed by vibration-controlled transient elastography (VCTE).

Source: https://euclinicaltrials.eu/ctis-public/view/2023-503497-21-00